EU clinical trial 2025-524157-13-00: A first in human study of people with chronic hepatitis B, where all participants will receive the new drug PBGENE-HBV. This study will use increasing dose amounts of the drug to see how safe and bearable it is. The study will also test how well PBGENE-HBV works and how it is processed by the body.
Protocol code: PBGENE-HBV-01
Sponsor: Precision Biosciences Inc. (Pharmaceutical company). Phase: Human Pharmacology (Phase I)- First administration to humans. Countries: Romania (ongoing, recruiting), France (authorised, recruiting).
Therapeutic area(s): Diseases [C] - Virus Diseases [C02]
Gender: Female, Male. Age: 18-64 years, 65+ years. Enrolment: 20.
Start date (EU): 2026-04-28. Decision date: 2026-04-08. Results received: No. Last updated: 2026-06-15.
Decision dates by country: FR: 2026-04-08, RO: 2026-04-14

Condition(s): Chronic Hepatitis B

Source: https://euclinicaltrials.eu/ctis-public/view/2025-524157-13-00